EU clinical trial 2025-520514-64-00: Phase 1 study with topical cream RLS-1496 in patients with plaque psoriasis or Eczema
Protocol code: RLS-1496-101
Sponsor: Rubedo Life Sciences Italy S.R.L. (Pharmaceutical company). Phase: Human Pharmacology (Phase I)- First administration to humans. Countries: Netherlands (ended).
Therapeutic area(s): Diseases [C] - Skin and Connective Tissue Diseases [C17]
Gender: Female, Male. Age: 18-64 years, 65+ years. Enrolment: 44.
Status: Ended. Start date (EU): 2025-04-04. End date (EU): 2026-03-11. Decision date: 2025-04-02. Results received: No. Last updated: 2025-09-16.

Condition(s): Atopic Dermatitis, Psoriasis

Source: https://euclinicaltrials.eu/ctis-public/view/2025-520514-64-00